EU clinical trial 2023-510371-55-00: A phase 1, randomized, double-blind, single-center, placebo-controlled first-in-human trial to assess the safety, tolerability, pharmacokinetics, and pharmacodynamics of RBD7007 in healthy participants
Protocol code: RC01T001
Sponsor: Ribocure Pharmaceuticals AB (Pharmaceutical company). Phase: Human Pharmacology (Phase I)- First administration to humans. Countries: Sweden (temporarily halted).
Therapeutic area(s): Diseases [C] - Immune System Diseases [C20]
Gender: Female, Male. Age: 18-64 years. Enrolment: 46.
Status: Temporarily halted. Start date (EU): 2024-11-14. Decision date: 2024-09-10. Results received: No. Last updated: 2024-09-10.

Condition(s): Complement-mediated diseases

Source: https://euclinicaltrials.eu/ctis-public/view/2023-510371-55-00